EU clinical trial 2024-518211-20-00: An open label, balanced, randomized, two-treatment, two-period, two-sequence, single dose crossover bioequivalence study comparing Enzalutamide film coated tablets 160 mg, Manufactured for Sun Pharmaceutical Industries Limited, India with XTANDI (Enzalutamide) 80 mg film coated tablets, Made by: Patheon Inc., 2100 Syntex Court, Mississauga, Ontario – Canada, Imported and registered by: Astellas Farma Brasil Importação e Distribuição de Medicamentos Ltda., São Paulo-SP, Brazil, in healthy adult, male subjects under fasting condition.
Protocol code: ENZAL-16-24
Sponsor: Sun Pharmaceutical Industries Limited (Pharmaceutical company). Phase: Human Pharmacology (Phase I)- Bioequivalence Study. Countries: Romania (ended).
Therapeutic area(s): Diseases [C] - Neoplasms [C04]
Gender: Male. Age: 18-64 years. Enrolment: 40.
Status: Ended. Start date (EU): 2025-04-14. End date (EU): 2025-08-11. Decision date: 2025-04-02. Results received: No. Last updated: 2025-04-02.

Condition(s): Prostate cancer

Source: https://euclinicaltrials.eu/ctis-public/view/2024-518211-20-00